EU clinical trial 2024-511959-18-01: Registry-based randomized trial to determine the role of Oxygen in acute Pulmonary Embolism
Protocol code: ROPE
Sponsor: Fundacion Para La Investigacion Biomedica Del Hospital Universitario Ramon Y Cajal (Laboratory/Research/Testing facility). Phase: Therapeutic confirmatory (Phase III). Countries: Spain (ongoing, recruiting), Italy (ongoing, recruiting).
Therapeutic area(s): Diseases [C] - Respiratory Tract Diseases [C08]; Diseases [C] - Cardiovascular Diseases [C14]
Gender: Female, Male. Age: 18-64 years, 65+ years. Enrolment: 4050.
Status: Ongoing, recruiting. Start date (EU): 2024-07-01. Decision date: 2024-05-27. Results received: No. Last updated: 2026-06-09.
Decision dates by country: ES: 2024-05-27, IT: 2025-08-26

Condition(s): Acute Pulmonary Embolism
Product: OXYGEN

Primary endpoint: Composite of hemodynamic collapse or death from any cause within 30 days after enrollment.
Endpoint(s): Death from any cause within 30 days after enrollment, Hemodynamic collapse within 30 days after enrollment, Pulmonary embolism-related mortality within 30 days after enrollment, Length of hospital stay, Death from any cause within 90 days after enrollment, Serious adverse events within 30 days after enrollment, Major bleeding within 30 days after enrollment, Recurrent symptomatic venous thromboembolism within 30 days after enrollment

Source: https://euclinicaltrials.eu/ctis-public/view/2024-511959-18-01